EU clinical trial 2022-503067-15-00: A Phase 3, Open-label Study of Adjunctive Ganaxolone (GNX) Treatment in Children and Adults with Tuberous Sclerosis Complex (TSC)-related Epilepsy (TrustTSC OLE)
Protocol code: 1042-TSC-3002
Sponsor: Marinus Pharmaceuticals Inc. (Pharmaceutical company). Phase: Therapeutic confirmatory (Phase III). Countries: Germany (ended), Spain (ended), Italy (ended), France (ended), Belgium (ended).
Therapeutic area(s): Diseases [C] - Nervous System Diseases [C10]
Gender: Female, Male. Age: 0-17 years, 18-64 years, 65+ years. Enrolment: 51.
Status: Ended. Start date (EU): 2023-10-02. End date (EU): 2024-11-25. Decision date: 2023-07-03. Results received: Yes. Last updated: 2024-09-11.
Decision dates by country: BE: 2023-07-06, IT: 2023-07-05, DE: 2023-07-10, FR: 2023-07-03, ES: 2023-07-05

Condition(s): Tuberous Sclerosis Complex (TSC) related epilepsy
Product: Ganaxolone

Primary endpoint: Incidence and severity of AEs, SAEs and withdrawals and dose-reductions due to AEs., Vital sign measurements including blood pressure, heart rate, respiratory rate, body temperature, height, and body weight., Physical, neurological, and developmental examination., 12-lead ECG., Clinical laboratory tests., C-SSRS.
Endpoint(s): Percentage change from baseline in 28-day seizure frequency during open-label treatment. (first year only), Percentage change from baseline in 28-day seizure frequency during the long-term treatment. (first year only), Number (%) of participants considered treatment responders. (first year only), CGI-I at the last scheduled study visit., Change from baseline in the quality-of-life scale SF-36. (first year only), Change from baseline in the percentage of seizure-free days during treatment, based on seizure type. (first year only), Change from baseline of CGI-CSID.

Source: https://euclinicaltrials.eu/ctis-public/view/2022-503067-15-00